EU clinical trial 2024-518394-34-00: Regenerative Stem Cell Therapy for Stroke in Europe 1
Protocol code: 38RC17.312
Sponsor: Centre Hospitalier Universitaire Grenoble Alpes (Hospital/Clinic/Other health care facility). Phase: Human Pharmacology (Phase I)- First administration to humans. Countries: France (authorised, recruitment pending).
Therapeutic area(s): Diseases [C] - Nervous System Diseases [C10]
Gender: Female, Male. Age: 18-64 years, 65+ years. Enrolment: 144.
Status: Authorised, recruitment pending. Decision date: 2024-11-05. Results received: No. Last updated: 2026-06-08.

Condition(s): stroke

Source: https://euclinicaltrials.eu/ctis-public/view/2024-518394-34-00